EU clinical trial 2024-511225-64-00: A Phase 2, randomized, double-blind, placebo-controlled, parallel group, 3-arm, multinational, multicenter, proof-of-concept study to evaluate the efficacy and safety of amlitelimab monotherapy by subcutaneous injection in adult participants with severe alopecia areata
Protocol code: DRI18180
Sponsor: Sanofi-Aventis Recherche & Developpement (Pharmaceutical company). Phase: Therapeutic exploratory (Phase II). Countries: Italy (ended), Netherlands (ended), Czechia (ended), Romania (ended), Germany (ended), France (ended), Spain (ended), Bulgaria (ended).
Therapeutic area(s): Diseases [C] - Skin and Connective Tissue Diseases [C17]
Gender: Female, Male. Age: 18-64 years, 65+ years. Enrolment: 74.
Status: Ended. Start date (EU): 2024-09-18. End date (EU): 2026-05-07. End date: 2026-05-21. Decision date: 2024-08-23. Results received: No. Last updated: 2026-03-24.
Decision dates by country: BG: 2024-08-28, NL: 2024-08-26, IT: 2024-08-23, FR: 2024-08-28, DE: 2024-08-26, RO: 2024-08-28, CZ: 2024-08-23, ES: 2024-08-27

Condition(s): Alopecia areata
Product: Amlitelimab, Amlitelimab matching placebo to test product

Primary endpoint: Change from baseline in SALT score at Week 36
Endpoint(s): Change from the baseline in SALT score at Week 24 (key secondary), Proportion of participants achieving a SALT score ≤20 at Weeks 24 and 36, Time to SALT score ≤20, Proportion of participants achieving a SALT score ≤10 at Weeks 24 and 36, Time to SALT score ≤10, Proportion of participants achieving a SALT50 at Weeks 24 and 36, Proportion of participants achieving a SALT75 at Weeks 24 and 36, Proportion of participants achieving a SALT90 at Weeks 24 and 36, Proportion of participants achieving ClinRO Measure for eyebrow (EB) Hair Loss 0 or 1 with ≥2-point improvement from baseline at Weeks 24 and 36 (among participants with ClinRO Measure for EB Hair Loss ≥2 at Baseline), Proportion of participants achieving ClinRO Measure for Eyelash (EL) Hair Loss 0 or 1 with ≥2-point improvement from baseline (among participants with ClinRO Measure for EL Hair Loss ≥2 at Baseline), Proportion of participants achieving a PGI-C response defined as a score of “moderately improved” or “greatly improved” at Weeks 24 and 36, Proportion of participants achieving a PGI-S response defined as a score of “mild“ or “none” at Weeks 24 and 36, Mean changes from baseline in SKINDEX-16AA at Weeks 24 and 36, Proportion of participants with PRO Scalp Hair Assessment score of 0 to 1 with ≥2-point improvement from baseline (among participants with PRO Scalp Hair Assessment score ≥3 at Baseline), Proportion of participants achieving grade 0 or 1 with ≥2-point improvement from baseline PRO Measure for EB Hair Loss (among participants with PRO Measure for EB Hair Loss ≥2 at Baseline), Proportion of participants achieving grade 0 or 1 with ≥2-point improvement from baseline PRO Measure for EL Hair Loss at Weeks 24 and 36 (among participants with PRO Measure for EL Hair Loss ≥2 at Baseline), Proportion of participants who experienced treatment-emergent adverse events (TEAEs), experienced treatment-emergent serious adverse event (TESAEs) and/or Treatment-Emergent adverse event of special interest (AESIs), Serum amlitelimab concentrations measured at prespecified timepoints, Incidence of ADAs) of amlitelimab at prespecified timepoints

Source: https://euclinicaltrials.eu/ctis-public/view/2024-511225-64-00